EU clinical trial 2024-519186-21-01: Efficacy of seven and fourteen days of antibiotic treatment in uncomplicated Staphylococcus aureus bacteremia: A randomized, non-blinded, non-inferiority interventional study
Sponsor: Hvidovre Hospital (Hospital/Clinic/Other health care facility). Phase: Therapeutic use (Phase IV). Countries: Denmark (ongoing, recruiting).
Therapeutic area(s): Diseases [C] - Bacterial Infections and Mycoses [C01]
Gender: Female, Male. Age: 18-64 years, 65+ years. Enrolment: 264.
Status: Ongoing, recruiting. Start date (EU): 2025-01-30. Decision date: 2025-01-30. Results received: No. Last updated: 2026-06-18.

Condition(s): Staphylococcus aureus bacteremia
Product: Cloxacillin "Stragen", pulver til injektions-/infusionsvæske, opløsning, Moxifloxacin Fresenius Kabi, Clindamycin ”Alternova”, hårde kapsler, Meropenem Fresenius Kabi, Bactocin, pulver til infusionsvæske, opløsning, Flucloxacillin ”Orion”, Daptomycin "Accord Healthcare", pulver til injektions-/infusionsvæske, opløsning, Gentamicin ”B. Braun”, infusionsvæske, opløsning, Linezolid "Teva", filmovertrukne tabletter, Cefuroxim Fresenius Kabi, Dicloxacillin "Alternova", hårde kapsler, Dicloxacillin "Alternova", hårde kapsler, Clindamycin "Abcur", injektions-/infusionsvæske, opløsning, Flucloxacillin "Orion", filmovertrukne tabletter, Piperacillin/Tazobactam "Sandoz", Cefuroxim Fresenius Kabi, Benzylpenicillin ”Panpharma”, pulver til injektions- og infusionsvæske, opløsning, Cefotaxim "MIP", pulver til injektions-/infusionsvæske, opløsning, Moxifloxacin "Accord", filmovertrukne tabletter, Meropenem Fresenius Kabi, Bactocin, pulver til infusionsvæske, opløsning, Clarithromycin "Accord", filmovertrukne tabletter, Clarithromycin ”Alternova”, pulver til infusionsvæske, opløsning, Levofloxacin "Macure", Linezolid Fresenius Kabi, Daptomycin "Accord Healthcare", pulver til injektions-/infusionsvæske, opløsning, Clarithromycin "Accord", filmovertrukne tabletter, Gentamicin ”B. Braun”, infusionsvæske, opløsning, Primcillin, filmovertrukne tabletter 400 mg, Primcillin, filmovertrukne tabletter 800 mg, Benzylpenicillin ”Panpharma”, pulver til injektions- og infusionsvæske, opløsning, Ceftriaxon "Kalceks", pulver til injektions-/infusionsvæske, opløsning, Ceftriaxon "Kalceks", pulver til injektions-/infusionsvæske, opløsning, Benzylpenicillin ”Panpharma”, pulver til injektions- og infusionsvæske, opløsning, Piperacillin/Tazobactam ”Sandoz”, pulver til infusionsvæske, opløsning, Ertapenem Fresenius Kabi, Sulfametoxazol med trimetoprim SAD, tabletter, Flucloxacillin ”Orion”, Amikacin "Macure", injektionsvæske, opløsning, Clindamycin ”Alternova”, hårde kapsler, Cefotaxim "MIP", pulver til injektions-/infusionsvæske, opløsning

Primary endpoint: 90-day survival without clinical or microbiological failure to treatment or relapse in patients treated with 7 days versus 14 days of antibiotic therapy
Endpoint(s): All-cause mortality days 14, 28, 90 and 180, Microbiological failure to treatment, Microbiological relapse, Clinical failure to treatment, Severe adverse events grade ≥3, Severe adverse events grade ≥3, Clostridium difficile infection, Multidrug-resistance organism, Health-associated costs associated the treatment lengths, Desirability of outcome ranking (DOOR), Hospital admissions during follow up

Source: https://euclinicaltrials.eu/ctis-public/view/2024-519186-21-01